EU clinical trial 2025-521493-33-00: Macroleave: Impact of discontinuation of long-term macrolides in stable Non Cystic Fibrosis Bronchiectasis : a multicenter randomized controlled trial
Protocol code: Macroleave
Sponsor: Centre Hospitalier Intercommunal Creteil (Hospital/Clinic/Other health care facility). Phase: Therapeutic confirmatory (Phase III). Countries: France (authorised, recruitment pending).
Therapeutic area(s): Diseases [C] - Respiratory Tract Diseases [C08]; Diseases [C] - Bacterial Infections and Mycoses [C01]
Gender: Female, Male. Age: 18-64 years, 65+ years. Enrolment: 185.
Status: Authorised, recruitment pending. Decision date: 2026-07-06. Results received: No. Last updated: 2026-07-06.

Condition(s): bronchiectasis unrelated to cystic fibrosis
Product: Azithromycin 500 mg Film-coated Tablets, Azithromycin 250 mg Film-coated Tablets

Primary endpoint: The primary efficacy endpoint is the annualized number of PE that have been confirmed through the event adjudication process
Endpoint(s): Time (days) to first exacerbation, Annual number of severe exacerbations, with hospitalization due to a respiratory failure, Quality-of-life score (Quality of Life-Bronchiectasis (QOL-B)16 and Bronchiectasis Impact Measure (BIM)) at inclusion, 1 year and 2 years, Emergence of macrolide-resistant strains of bacteria or mycobacteria, at inclusion, 12 and 24 months, Forced expiratory volume in 1 second (FEV1) and forced vital capacity (FVC), at inclusion, 12 and 24 months, Number of days between randomization and a new prescription of preventive treatment for exacerbations (macrolides, anti-inflammatory such as brenzocatib, long-term antibiotic therapy), Prognostic factors for macrolide discontinuation failure (age, severity of the disease, Pseudomonas colonization and duration of macrolides exposition before the beginning of the trial…) will be explored by using uni- and multivariable logistic regression

Source: https://euclinicaltrials.eu/ctis-public/view/2025-521493-33-00